EU clinical trial 2025-524448-36-00: A Sequential Phase 2/3, Single-Arm, Open-Label Study in Adults Followed by a Randomized, Placebo-Controlled, Double-Blind, Multicenter Study to Evaluate the Efficacy and Safety of Pegcetacoplan in Adults and Adolescents with Focal Segmental Glomerulosclerosis
Protocol code: APL2-FSG-319
Sponsor: Apellis Pharmaceuticals Inc. (Pharmaceutical company). Phase: Phase II and Phase III (Integrated). Countries: France (authorised, recruitment pending), Portugal (authorised, recruitment pending), Spain (authorised, recruitment pending), Slovakia (authorised, recruitment pending), Italy (authorised, recruitment pending), Germany (authorised, recruitment pending), Poland (authorised, recruitment pending).
Therapeutic area(s): Diseases [C] - Female Urogenital Diseases and Pregnancy Complications [C13]; Diseases [C] - Male Urogenital Diseases [C12]
Gender: Female, Male. Age: 0-17 years, 18-64 years, 65+ years. Enrolment: 97.
Status: Authorised, recruitment pending. Decision date: 2026-07-14. Results received: No. Last updated: 2026-07-20.
Decision dates by country: ES: 2026-07-14, IT: 2026-07-15, FR: 2026-07-20, PL: 2026-07-20, PT: 2026-07-14, DE: 2026-07-14, SK: 2026-07-14

Condition(s): Focal segmental glomerulosclerosis (FSGS)
Product: Pegcetacoplan matching placebo is a sterile solution of 10 mM acetate buffer, pH 5.0, containing 4.1% sorbitol in a single-use glass vial., ASPAVELI 1 080 mg solution for infusion

Primary endpoint: Phase 2: Evaluate the efficacy of pegcetacoplan in terms of change from baseline in log-transformed urine protein to creatinine ratio (uPCR) Phase 3: Change from baseline in log-transformed urine protein to creatinine ratio (uPCR)
Endpoint(s): Phase 2: Evaluate the efficacy of pegcetacoplan in terms of change from baseline in log-transformed urine albumin to creatinine ratio (uACR) Phase 3: Change from Baseline in log-transformed urine protein to creatinine ratio (uPCR); Proportion of participants achieving Complete Remission; Slope of estimated Glomerular Filtration Rate (eGFR)

Source: https://euclinicaltrials.eu/ctis-public/view/2025-524448-36-00